EU clinical trial 2023-508047-40-00: A Phase 3, Randomized, Open-label, Multicenter Study of Sacituzumab Tirumotecan (sac-TMT, MK-2870) Maintenance Treatment With or Without Bevacizumab Versus Standard of Care in Participants With Newly Diagnosed Advanced HRD-Negative Ovarian Cancer Following First-line Platinum-based Chemotherapy (TroFuse-021/ENGOTov85/ GOG-3102)
Protocol code: MK-2870-021
Sponsor: Merck Sharp & Dohme LLC (Pharmaceutical company). Phase: Therapeutic confirmatory (Phase III). Countries: Norway (ongoing, recruiting), Ireland (authorised, recruiting), Spain (ongoing, recruiting), Greece (ongoing, recruiting), France (ongoing, recruiting), Poland (ongoing, recruiting), Denmark (ongoing, recruiting), Austria (authorised, recruiting), Hungary (ongoing, recruiting), Belgium (ongoing, recruiting), Czechia (ongoing, recruiting), Finland (ongoing, recruiting), Germany (authorised, recruitment pending), Italy (ongoing, recruiting), Sweden (ongoing, recruiting).
Therapeutic area(s): Diseases [C] - Neoplasms [C04]
Gender: Female. Age: 18-64 years, 65+ years. Enrolment: 349.
Start date (EU): 2026-04-30. Decision date: 2026-04-28. Results received: No. Last updated: 2026-06-25.
Decision dates by country: AT: 2026-04-30, BE: 2026-04-29, CZ: 2026-04-28, DK: 2026-04-28, FI: 2026-04-28, DE: 2026-04-29, HU: 2026-04-30, IE: 2026-05-01, IT: 2026-04-29, SE: 2026-04-28, NO: 2026-04-28, PL: 2026-04-30, GR: 2026-04-29, FR: 2026-04-28, ES: 2026-04-28

Condition(s): Ovarian cancer
Product: MK-2870, Avastin 25 mg/ml concentrate for solution for infusion., Avastin 25 mg/ml concentrate for solution for infusion., MVASI 25 mg/mL concentrate for solution for infusion, MVASI 25 mg/mL concentrate for solution for infusion

Primary endpoint: Progression-Free Survival (PFS)
Endpoint(s): Overall Survival (OS), Second Progression-Free Survival (PFS2), Number of Participants Who Experience an Adverse Event (AE), Number of Participants Who Discontinue Study Treatment Due to an AE, Change From Baseline in Global Health Status/Quality of Life (GHS/QoL) Combined Score (Items 29 and 30) Using the European Organisation for Research and Treatment of Cancer QoL Questionnaire-Core 30 (EORTC QLQ-C30), Change From Baseline in Physical Functioning Combined Score (Items 1 to 5) Using EORTC QLQ-C30, Change From Baseline in Role Functioning Combined Score (Items 6 and 7) Using EORTC QLQ-C30, Change From Baseline in Abdominal/Gastrointestinal (GI) Symptoms Combined Score (Items 31 to 36) Using the EORTC QLQ-Ovarian Cancer Module 28 (OV28)

Source: https://euclinicaltrials.eu/ctis-public/view/2023-508047-40-00